EU clinical trial 2025-522379-26-00: Dose-finding exploratory study on Azithromycin on senescence in healthy volunteers
Protocol code: AZISEN
Sponsor: IRCCS Ospedale Policlinico San Martino (Hospital/Clinic/Other health care facility). Phase: Therapeutic exploratory (Phase II). Countries: Italy (not authorised).
Therapeutic area(s): Phenomena and Processes [G] - Cell Physiological Phenomena [G04]; Phenomena and Processes [G] - Physical Phenomena [G01]; Phenomena and Processes [G] - Biological Phenomena [G16]
Gender: Female, Male. Age: 18-64 years, 65+ years. Enrolment: 12.
Status: Not authorised. Decision date: 2025-09-12. Results received: No. Last updated: 2025-09-12.

Condition(s): Cellular senescence and associated inflammatory status
Product: Azitromicina Teva Italia 200 mg/5 ml polvere per sospensione orale

Primary endpoint: Primary endpoints of this pilot study will be changes in 1) senescent cell abundance in the blood cells by p16INK4A evaluation; 2) other serum markers of aging/inflammaging
Endpoint(s): To determine the minimum effective dose, To examine the safety

Source: https://euclinicaltrials.eu/ctis-public/view/2025-522379-26-00